EU clinical trial 2026-525256-29-00: Randomized, open-label, laboratory-blinded, balanced, single dose, 3-treatment, 6-sequence, 3-period crossover comparative bioavailability study comparing Finerenone, 20 mg, film-coated tablets (Prototype 1, Prototype 2) and Kerendia, 20 mg, film-coated tablets under fasting conditions in healthy participants.
Protocol code: RDW483/0155/2
Sponsor: ZAKLADY FARMACEUTYCZNE POLPHARMA S.A. (Pharmaceutical company). Phase: Human Pharmacology (Phase I)- Other. Countries: Czechia (ended).
Therapeutic area(s): Diseases [C] - Cardiovascular Diseases [C14]
Gender: Female, Male. Age: 18-64 years. Enrolment: 36.
Status: Ended. Start date (EU): 2026-03-13. End date (EU): 2026-04-09. Decision date: 2026-03-04. Results received: No. Last updated: 2026-03-04.

Condition(s): Comparative bioavailability study under fasting conditions

Source: https://euclinicaltrials.eu/ctis-public/view/2026-525256-29-00